EU clinical trial 2024-515252-20-00: A Phase I/II Open-Label, Multi-centre Study to Assess the Safety and Tolerability of Roginolisib in Combination with an Approved JAK inhibitor in Patients with Myelofibrosis (MF) who are Unresponsive to JAK inhibitors (HEMA-MED)
Sponsor: iOnctura SA (Pharmaceutical company). Phase: Phase I and Phase II (Integrated)- Other. Countries: Spain (ongoing, recruiting), Italy (ongoing, recruiting).
Therapeutic area(s): Diseases [C] - Neoplasms [C04]; Diseases [C] - Hemic and Lymphatic Diseases [C15]
Gender: Female, Male. Age: 18-64 years, 65+ years. Enrolment: 27.
Status: Ongoing, recruiting. Start date (EU): 2025-03-14. Decision date: 2025-01-17. Results received: No. Last updated: 2026-08-04.
Decision dates by country: ES: 2025-01-17, IT: 2025-01-24

Condition(s): Myelofibrosis (MF) unresponsive to JAK inhibitors
Product: FEDRATINIB, IOA-244, RUXOLITINIB, MOMELOTINIB DIHYDROCHLORIDE MONOHYDRATE

Primary endpoint: Safety measured by AEs, 12-lead ECG, serum chemistry and haematology laboratory parameters, vital signs, physical examinations
Endpoint(s): Changes in peripheral blood Tregs from baseline at Week 12 and continued reduction over time, Splenic response rate (SRR) of ≥15%, ≥25% and ≥35% reduction in spleen volume at 12 and 24 weeks compared to baseline, as assessed by MRI/CT, Duration of spleen response as determined every 12 weeks, Proportion of patients with transfusion independence at 12 and 24 weeks where applicable, Overall Survival (OS) defined as the time from the date of the first dose of study treatment until death from any cause, Proportion of patients who have any reduction in Total Symptom Score (TSS) at 12 and 24 weeks compared to baseline as measured by Myelofibrosis Symptom Assessment Form (MFSAF), Proportion of patients who have a reduction of ≥25% and ≥50% in TSS at 12 and 24 weeks compared to baseline as measured by Myelofibrosis Symptom Assessment Form (MFSAF), Mean change in TSS as measured by Myelofibrosis Symptom Assessment Form (MFSAF) from baseline at 12 and 24 weeks, Time to the first ≥50% reduction compared to baseline in TSS as measured by Myelofibrosis Symptom Assessment Form (MFSAF), Duration of TSS response as measured by MFSAF (e.g., duration of TSS ≥25% and ≥50%), Concentration of roginolisib at pre-dose and steady state levels (including Area under the curve [AUC], population PK)

Source: https://euclinicaltrials.eu/ctis-public/view/2024-515252-20-00